EU clinical trial 2023-508969-32-00: A single-dose, open-label study of TX000045 in patients with CpcPH or IpcPH and HFpEF.
Protocol code: TX000045-002
Sponsor: Tectonic Therapeutic Inc. (Pharmaceutical company). Phase: Human Pharmacology (Phase I)- Other. Countries: Netherlands (ended).
Therapeutic area(s): Diseases [C] - Cardiovascular Diseases [C14]
Gender: Female, Male. Age: 18-64 years, 65+ years. Enrolment: 10.
Status: Ended. Start date (EU): 2024-07-08. End date (EU): 2025-09-02. End date: 2025-09-03. Decision date: 2024-04-04. Results received: No. Last updated: 2025-09-02.

Condition(s): Combined postcapillary and precapillary pulmonary hypertension / Isolated postcapillary pulmonary hypertension

Source: https://euclinicaltrials.eu/ctis-public/view/2023-508969-32-00